EU clinical trial 2024-516097-30-00: AIR. ANTIBIOTIC THERAPY IN RESPIRATORY TRACT INFECTIONS A controlled randomized, open label, multicenter, non-inferiority trial evaluating an individualized antibiotic treatment duration based on patient clinical response, evaluated through connected devices, for suspected community acquired pneumonia in the community setting
Protocol code: P160929J
Sponsor: Assistance Publique Hopitaux De Paris (Hospital/Clinic/Other health care facility). Phase: Therapeutic use (Phase IV). Countries: France (authorised, recruitment pending).
Therapeutic area(s): Diseases [C] - Respiratory Tract Diseases [C08]
Gender: Female, Male. Age: 18-64 years, 65+ years. Enrolment: 500.
Status: Authorised, recruitment pending. Decision date: 2024-11-13. Results received: No. Last updated: 2026-07-08.

Condition(s): Community acquired pneumonia (CAP)
Product: AZITHROMYCIN, DOXYCYCLINE, PRISTINAMYCIN, AMOXICILLIN AND BETA-LACTAMASE INHIBITOR, AMOXICILLIN, CLARITHROMYCIN

Primary endpoint: Percentage of cure at Day 15 after the start of treatment
Endpoint(s): Percentage of cure at Day 30, Duration of antibiotic treatment for the CAP and in case of other causes, Frequency and severity of adverse events between the 2 study arms, Patients' evolution of pneumonia symptoms and quality of life between the 2 study arms, A composite endpoint defined by the observation of one of the events characterizing the response to antibiotic treatment, among: clinical failure or; microbiological failure or; emergence of antibiotic resistance, Time to clinical recovery (regardless of microbiological recovery or resistance failure), Presence or absence of antimicrobial resistance at any point during follow-up, Association between specific antibiotics and respiratory microbiome evolution, Association between specific antibiotics and gut microbiome evolution, Duration of antimicrobial treatment

Source: https://euclinicaltrials.eu/ctis-public/view/2024-516097-30-00